EU clinical trial 2024-513330-38-00: Impact Of The Gut Microbiota On Host Cells Energy Metabolism in Health And In Inflammatory Bowel Disease (ENERGISED-Clinic)
Protocol code: APHP221107
Sponsor: Assistance Publique Hopitaux De Paris (Hospital/Clinic/Other health care facility). Phase: Therapeutic exploratory (Phase II). Countries: France (ongoing, recruiting).
Therapeutic area(s): Diseases [C] - Digestive System Diseases [C06]
Gender: Female, Male. Age: 18-64 years. Enrolment: 45.
Status: Ongoing, recruiting. Start date (EU): 2026-01-02. Decision date: 2025-06-13. Results received: No. Last updated: 2025-06-13.

Condition(s): Healthy volunteers : Healthy adults with no history of gastrointestinal disease; Patients with IBD in remission
Product: AMPHOTERICIN B, VANCOMYCIN, Gentamicin_APHP

Primary endpoint: Energy metabolism of major immune cell types for peripheral blood will be assessed on a blood sample. The energy metabolism will be assessed by single-cell energetic metabolism by profiling translation inhibition
Endpoint(s): Impact of the gut microbiota and its alterations in inflammatory bowel disease on the fate of microbiota-derived carbon sources in host cells: we will use a strategy based on stable isotope probing (SIP). The participants will receive orally food grade inulin from Chicory (2% labelled with 13C) at H0 on day 0 (v1) and day 7 (v2) for healthy adults and day 0 (v1) only for patients with IBD. The incorporation of 13C in metabolites will then be assessed, Identification of the intestinal bacteria responsible for the metabolism of the labeled inulin: we will use SIP-DNA and SIP-RNA sequencing approaches: DNA and RNA will be extracted from each fecal samples obtained

Source: https://euclinicaltrials.eu/ctis-public/view/2024-513330-38-00